EU clinical trial 2024-513518-37-00: A phase II, open-label, multicenter trial to investigate the clinical activity and safety of Cabozantinib in combination with avelumab in patients refractory to standard chemotherapy with advanced neuroendocrine neoplasias G3 (NEN G3)
Protocol code: CaboAveNEC
Sponsor: Universitaetsmedizin der Johannes Gutenberg-Universitaet Mainz KöR (Hospital/Clinic/Other health care facility). Phase: Therapeutic exploratory (Phase II). Countries: Germany (ended).
Therapeutic area(s): Diseases [C] - Neoplasms [C04]
Gender: Female, Male. Age: 18-64 years, 65+ years. Enrolment: 30.
Status: Ended. Start date (EU): 2022-03-15. End date (EU): 2025-01-03. Decision date: 2024-06-26. Results received: Yes. Last updated: 2024-06-26.

Condition(s): Advanced neuroendocrine neoplasias G3 (NEN G3) (excluding SCLC and Merkel cell carcinomas)
Product: CABOMETYX 20 mg film-coated tablets, CABOMETYX 40 mg film-coated tablets, Avelumab

Primary endpoint: Disease control rate (DCR: CR, PR, SD) according to iRECIST after 16 weeks from start of treatment until documented disease progression (PD)
Endpoint(s): Disease control rate (DCR) at week 8, week 24, week 48, Objective response rate (ORR), Best overall response (BOR), Duration of disease control (DDC), Time to response (TTR), Progression-free survival time (PFS), Evaluation of tumor response according to RECIST 1.1, Overall survival (OS), Quality of life (QoL) assessed by EORTC QLQ-C30, Number, severity, and duration of treatment-emergent AEs according to NCI-CTCAE v5.0, Dose reduction of study drugs, Treatment interruption or termination of study drugs due to adverse events

Source: https://euclinicaltrials.eu/ctis-public/view/2024-513518-37-00